EU clinical trial 2023-508307-21-00: A Phase 3, Randomized, Double-Blind, Placebo-Controlled, Efficacy and Safety Study of Pitolisant Followed by an Open-Label Extension in Patients with Prader-Willi Syndrome
Protocol code: HBS-101-CL-312
Sponsor: Harmony Biosciences LLC (Pharmaceutical company). Phase: Therapeutic confirmatory (Phase III). Countries: Poland (ongoing, recruiting), Sweden (ongoing, recruiting), Italy (ongoing, recruiting), France (ongoing, recruiting), Germany (ongoing, recruiting), Romania (ongoing, recruiting), Spain (ongoing, recruiting), Belgium (ongoing, recruiting), Denmark (ongoing, recruiting), Czechia (ended).
Therapeutic area(s): Diseases [C] - Congenital, Hereditary, and Neonatal Diseases and Abnormalities [C16]; Phenomena and Processes [G] - Genetic Phenomena [G05]
Gender: Female, Male. Age: 0-17 years, 18-64 years, 65+ years. Enrolment: 67.
Start date (EU): 2025-03-19. Decision date: 2025-02-10. Results received: No. Last updated: 2026-04-15.
Decision dates by country: IT: 2025-02-12, DK: 2025-03-05, DE: 2025-02-13, ES: 2025-02-10, BE: 2025-02-11, FR: 2025-03-05, RO: 2025-02-14, SE: 2025-02-12, CZ: 2025-03-05, PL: 2025-02-13

Condition(s): Prader-Willi syndrome
Product: HBS-101, White, round, plain, biconvex film-coated tablet. Matching 4.45 mg tablet is 3.7 mm in diameter., White, round, plain, biconvex film-coated tablet. matching 17.8 mg tablet is 7.5 mm in diameter., WAKIX, HBS-101, WAKIX

Primary endpoint: Efficacy: Change in severity of EDS as measured by PROMIS SRI T-score from Baseline to the end of the Double Blind Treatment Period (Day 77)
Endpoint(s): Efficacy: Change in severity of irritable and disruptive behaviors as measured by ABC-C Irritability Domain score from Baseline to the end of the Double-Blind Treatment Period (Day 77), Efficacy: Change in overall severity of EDS as measured by the CaGI-S for EDS score from Baseline to the end of the Double-Blind Treatment Period (Day 77), Efficacy: Change in overall severity of EDS as measured by the CGI-S for EDS score from Baseline to the end of the Double-Blind Treatment Period (Day 77), Efficacy: Change in overall severity of irritable and disruptive behaviors as measured by the CaGI-S for Irritable and/or Disruptive Behaviors score from Baseline to the end of the Double-Blind Treatment Period (Day 77), Efficacy: Change in severity of hyperphagia as measured by HQ CT score in conjunction with the FSZQ score, from Baseline to the end of the Double-Blind Treatment Period (Day 77), Efficacy: Change in severity of EDS as measured by ESS CHAD (parent/caregiver version) total score from Baseline to the end of the Double-Blind Treatment Period (Day 77), Efficacy: Change in severity of other behavioral problems as measured by the ABC-C Hyperactivity/Noncompliance, Inappropriate Speech, Social Withdrawal, and Stereotypic Behavior Domain scores from Baseline to the end of the Double-Blind Treatment Period (Day 77), Safety and Pharmacokinetic: Percentage of patients reporting TEAEs during each study period and during the entire study, Safety and Pharmacokinetic: Measured concentration of pitolisant

Source: https://euclinicaltrials.eu/ctis-public/view/2023-508307-21-00